EU clinical trial 2024-519651-28-00: A trial to find out how well CVHNLC works at different dose levels and how safe it is in combination with pembrolizumab in patients with lung cancer that cannot be completely cured.
Protocol code: CV-HNLC-001
Sponsor: CureVac SE (Pharmaceutical company). Phase: Human Pharmacology (Phase I)- First administration to humans. Countries: Spain (ended), France (ended).
Therapeutic area(s): Diseases [C] - Respiratory Tract Diseases [C08]; Diseases [C] - Neoplasms [C04]
Gender: Female, Male. Age: 18-64 years, 65+ years. Enrolment: 30.
Status: Ended. End date (EU): 2026-05-11. Decision date: 2025-06-03. Results received: No. Last updated: 2025-06-04.
Decision dates by country: FR: 2025-06-04, ES: 2025-06-03

Condition(s): metastatic squamous non-small cell lung cancer

Source: https://euclinicaltrials.eu/ctis-public/view/2024-519651-28-00